EU clinical trial 2023-508058-24-01: A PHASE I STUDY OF THE CEACAM5 x CD3 ANTIBODY NILK-2301 IN COLORECTAL CANCER
Protocol code: LCB-2301-001
Sponsor: NovImmune S.A. (Pharmaceutical company). Phase: Human Pharmacology (Phase I)- First administration to humans. Countries: Spain (ongoing, recruiting).
Therapeutic area(s): Diseases [C] - Digestive System Diseases [C06]
Gender: Female, Male. Age: 18-64 years. Enrolment: 12.
Status: Ongoing, recruiting. Start date (EU): 2024-04-05. Decision date: 2024-03-06. Results received: No. Last updated: 2025-10-06.

Condition(s): LOCALLY ADVANCED OR METASTATIC LOW TUMOR VOLUME COLORECTAL CANCER

Source: https://euclinicaltrials.eu/ctis-public/view/2023-508058-24-01